EU clinical trial 2023-503406-36-00: INCB 54828-801: An Open-Label, Multicenter, Rollover Study to Provide Continued Treatment for Participants With Advanced Malignancies Previously Enrolled in Studies of Pemigatinib
Protocol code: INCB 54828-801
Sponsor: Incyte Corp. (Pharmaceutical company). Phase: Therapeutic exploratory (Phase II). Countries: Italy (ended).
Therapeutic area(s): Diseases [C] - Neoplasms [C04]
Gender: Female, Male. Age: 18-64 years, 65+ years. Enrolment: 4.
Status: Ended. Start date (EU): 2021-12-13. End date (EU): 2023-05-11. End date: 2024-04-11. Decision date: 2023-06-09. Results received: Yes. Last updated: 2023-06-09.

Condition(s): Male and female participants at least 18 years of age who are actively receiving treatment with pemigatinib under a parent protocol and receiving clinical benefit and who do not have access to pemigatinib outside of a clinical trial
Product: Pemazyre 13.5 mg tablets, Pemazyre 4.5 mg tablets, Pemazyre 9 mg tablets, Pemigatinib

Primary endpoint: Frequency and nature of AEs and SAEs as assessed by CTCAE v5.0.

Source: https://euclinicaltrials.eu/ctis-public/view/2023-503406-36-00